EU clinical trial 2023-505827-29-00: (19429) A phase 1/2 open-label safety and dose-finding study of BAY 2599023 (DTX201), an adeno-associated virus (AAV) hu37-mediated gene transfer of B-domain deleted human factor VIII, in adults with severe hemophilia A
Protocol code: 19429
Sponsor: Bayer AG (Pharmaceutical company). Phase: Phase I and Phase II (Integrated)- First administration to humans. Countries: Netherlands (ended), Germany (ended), France (ended), Bulgaria (ended).
Therapeutic area(s): Diseases [C] - Hemic and Lymphatic Diseases [C15]
Gender: Male. Age: 18-64 years, 65+ years. Enrolment: 6.
Status: Ended. Start date (EU): 2018-10-30. End date (EU): 2026-05-26. Decision date: 2023-12-18. Results received: No. Last updated: 2026-02-25.
Decision dates by country: FR: 2024-01-16, DE: 2023-12-19, NL: 2023-12-18, BG: 2024-02-09

Condition(s): Hemophilia A
Product: BAY 2599023

Primary endpoint: Incidence of adverse events, treatment-emergent adverse events, serious adverse events and Adverse events/serious adverse events of special interest
Endpoint(s): Expression pattern of FVIII activity., Proportion of patients in the respective dose step, that reached an expression of FVIII above 5% at 6 months and 12 months following the IV administration of BAY2599023

Source: https://euclinicaltrials.eu/ctis-public/view/2023-505827-29-00